EU clinical trial 2023-504800-28-00: This is a clinical trial (study), to be conducted at multiple clinical sites, of an oral study drug (EP262) that will be investigated in adult participants with Chronic Inducible Urticaria (CIndU) to assess if it is safe and improves reactions to known CIndU triggers.
Protocol code: EP-262-102
Sponsor: Escient Pharmaceuticals Inc. (Pharmaceutical company). Phase: Human Pharmacology (Phase I)- Other. Countries: Germany (ended), Netherlands (ended), Spain (ended).
Therapeutic area(s): Diseases [C] - Skin and Connective Tissue Diseases [C17]
Gender: Female, Male. Age: 18-64 years, 65+ years. Enrolment: 14.
Status: Ended. Start date (EU): 2024-02-23. End date (EU): 2024-10-22. End date: 2024-10-23. Decision date: 2023-12-04. Results received: No. Last updated: 2024-08-22.
Decision dates by country: NL: 2023-12-13, DE: 2023-12-04, ES: 2023-12-11

Condition(s): Chronic Inducible Urticaria

Source: https://euclinicaltrials.eu/ctis-public/view/2023-504800-28-00